EU clinical trial 2024-511848-55-00: A double-blind randomized placebo-controlled four-arm trial to assess the efficacy of oral bicarbonate and intravenous butylscopolamine bromide to facilitate spontaneous (non-operative) delivery in pregnant female participants with induction of labor.
Sponsor: Oslo University Hospital HF (Hospital/Clinic/Other health care facility). Phase: Therapeutic confirmatory (Phase III). Countries: Norway (ongoing, recruitment ended).
Therapeutic area(s): Diseases [C] - Female Urogenital Diseases and Pregnancy Complications [C13]
Gender: Female. Age: 18-64 years. Enrolment: 3000.
Status: Ongoing, recruitment ended. Start date (EU): 2023-01-03. Decision date: 2024-10-09. Results received: No. Last updated: 2024-10-09.

Condition(s): childbirth
Product: Placebo tablets with same size and appearance as the bicarbonate tablets. Contents of placebo tablets are described in the SmPC., Buscopan Ampoules 20mg/ml solution for injection., Sodium Chloride Fresenius Kabi Italia 0.9 % Solution for infusion , Sodium Bicarbonate 500 mg Capsules

Primary endpoint: Spontaneous vs operative delivery. Operative delivery defined as cesarean delivery, vacuum or forceps

Source: https://euclinicaltrials.eu/ctis-public/view/2024-511848-55-00